EU clinical trial 2023-509843-28-00: An open label, multicenter roll-over extension program (REP) to characterize the long-term safety and tolerability of iptacopan (LNP023) in patients with Paroxysmal Nocturnal Hemoglobinuria (PNH) who have completed PNH Phase 2 and Phase 3 studies with iptacopan.
Protocol code: CLNP023C12001B
Sponsor: Novartis Pharma AG (Pharmaceutical company). Phase: Therapeutic confirmatory (Phase III). Countries: Germany (ended), Italy (ongoing, recruitment ended), Czechia (ongoing, recruitment ended), France (ongoing, recruitment ended), Spain (ended), Netherlands (ended), Lithuania (ongoing, recruitment ended).
Therapeutic area(s): Diseases [C] - Immune System Diseases [C20]
Gender: Female, Male. Age: 18-64 years, 65+ years. Enrolment: 86.
Start date (EU): 2021-11-10. Decision date: 2024-06-05. Results received: No. Last updated: 2026-02-04.
Decision dates by country: DE: 2024-06-06, ES: 2024-06-06, CZ: 2024-06-10, NL: 2024-06-05, IT: 2024-06-12, LT: 2024-06-26, FR: 2024-06-05

Condition(s): Paroxysmal Nocturnal Hemoglobinuria (PNH)
Product: IPTACOPAN, LNP023

Primary endpoint: Safety evaluations including but not limited to adverse events/serious adverse events, safety laboratory parameters, vital signs, etc., through End of Study visit
Endpoint(s): Response defined as maintaining sustained hemoglobin levels ≥ 12 g/dL in the absence of transfusions evaluated over yearly follow up intervals, Absence of administration of packed-red blood cell transfusions evaluated over yearly follow up intervals, Occurrences of breakthrough hemolysis and of Major Adverse Vascular Events, MAVE occurring evaluated over yearly follow up intervals

Source: https://euclinicaltrials.eu/ctis-public/view/2023-509843-28-00